EU clinical trial 2024-513577-43-00: A multicentric, open-label, non-randomized study to evaluate the pharmacokinetic, safety and tolerability of ITF2357 given as an oral single 50 mg dose in participants with chronic hepatic impairment relative to matched participants with normal hepatic function.
Protocol code: ITF2357-60
Sponsor: Italfarmaco S.p.A. (Pharmaceutical company). Phase: Human Pharmacology (Phase I)- Other. Countries: Bulgaria (ended), France (ended).
Therapeutic area(s): Not possible to specify
Gender: Female, Male. Age: 18-64 years, 65+ years. Enrolment: 24.
Status: Ended. Start date (EU): 2025-05-16. End date (EU): 2025-08-14. Decision date: 2025-04-30. Results received: No. Last updated: 2025-05-05.
Decision dates by country: BG: 2025-04-30, FR: 2025-05-05

Condition(s): Participants with normal hepatic function, Participants with moderate HI, Participants with mild HI

Source: https://euclinicaltrials.eu/ctis-public/view/2024-513577-43-00